EU clinical trial 2023-509441-13-00: A multicenter, open-label, Phase IIb study to evaluate the efficacy, safety and pharmacokinetics of rilzabrutinib in patients with warm autoimmune hemolytic anemia (LUMINA 2)
Protocol code: ACT17209
Sponsor: Sanofi-Aventis Recherche & Developpement (Pharmaceutical company). Phase: Therapeutic exploratory (Phase II). Countries: Italy (ongoing, recruitment ended), Spain (ended), Denmark (ongoing, recruitment ended).
Therapeutic area(s): Diseases [C] - Immune System Diseases [C20]
Gender: Female, Male. Age: 18-64 years, 65+ years. Enrolment: 13.
Start date (EU): 2022-01-31. Decision date: 2024-02-27. Results received: No. Last updated: 2025-08-27.
Decision dates by country: DK: 2024-02-27, ES: 2024-03-01, IT: 2024-02-28

Condition(s): Warm autoimmune hemolytic anemia
Product: Rilzabrutinib

Primary endpoint: Proportion of participants with overall hemoglobin response, Proportion of participants who maintain durable response achieved during Part A or achieve a durable response during Part B and have a hemoglobin response
Endpoint(s): Proportion of participants with durable hemoglobin response, Median time from baseline to first hemoglobin response, Frequency of rescue therapy (any wAIHA-directed therapy other than predniso[lo]ne or transfusion) received, Change from baseline in FACIT-Fatigue scale score, Safety assessments

Source: https://euclinicaltrials.eu/ctis-public/view/2023-509441-13-00